EU clinical trial 2022-500779-29-00: MORPHINE PHARMACOKINETICS AND –DYNAMICS IN HEALTHY VOLUNTEERS AND PATIENTS WITH OBESITY AND OBSTRUCTIVE SLEEP APNOEA. -AN INVESTIGATOR INITIATED, CLINICAL STUDY OF THE IMPACT OF OBESITY AND SLEEP APNOEA ON THE PHARMACOLOGY OF MORPHINE
Sponsor: Sydvestjysk Sygehus (Hospital/Clinic/Other health care facility). Phase: Therapeutic exploratory (Phase II). Countries: Denmark (ended).
Therapeutic area(s): Phenomena and Processes [G] - Metabolism [G03]; Diseases [C] - Hormonal diseases [C19]; Analytical, Diagnostic and Therapeutic Techniques and Equipment [E] - Anesthesia and Analgesia [E03]
Gender: Female, Male. Age: 18-64 years. Enrolment: 140.
Status: Ended. Start date (EU): 2022-12-01. End date (EU): 2025-12-16. Decision date: 2022-09-26. Results received: No. Last updated: 2025-12-16.

Condition(s): Obesity and Obstructive Sleep apnoea
Product: NALOXONE HYDROCHLORIDE, MORPHINE HYDROCHLORIDE, LIDOCAINE HYDROCHLORIDE

Primary endpoint: The primary endpoints is the area under the curve (AUC)morphine, and maximum plasma concentration (CMAX)morphine
Endpoint(s): The secondary endpoints is reported stimulus intensity during the Heat, Cold, Bone and Muscle Pressure Tests, ie the quantitive sensory testing

Source: https://euclinicaltrials.eu/ctis-public/view/2022-500779-29-00